EU clinical trial 2024-512197-99-00: A study to investigate the effect of oral ticagrelor on the pharmacokinetics of oral rosuvastatin when given in healthy participants
Protocol code: D3560C00817
Sponsor: AstraZeneca AB (Pharmaceutical company). Phase: Human Pharmacology (Phase I)- Other. Countries: Germany (ended).
Therapeutic area(s): Not possible to specify
Gender: Female, Male. Age: 18-64 years. Enrolment: 28.
Status: Ended. Start date (EU): 2024-07-12. End date (EU): 2024-10-09. Decision date: 2024-07-12. Results received: No. Last updated: 2024-07-12.

Condition(s): Clinical trial healthy volunteer

Source: https://euclinicaltrials.eu/ctis-public/view/2024-512197-99-00